EU clinical trial 2025-521020-30-00: A Phase 1 study to evaluate the effect of BV100 on the pharmacokinetics of polymyxin B in healthy volunteers
Protocol code: BV100-011
Sponsor: Bioversys S.A.S. (Pharmaceutical company). Phase: Human Pharmacology (Phase I)- Other. Countries: Austria (ended).
Therapeutic area(s): Diseases [C] - Respiratory Tract Diseases [C08]
Gender: Female, Male. Age: 18-64 years. Enrolment: 16.
Status: Ended. Start date (EU): 2026-03-12. End date (EU): 2026-07-10. Decision date: 2026-03-01. Results received: No. Last updated: 2026-03-01.

Condition(s): Healthy volunteer trial. Intended indication: treatment of infections due to A. baumannii.

Source: https://euclinicaltrials.eu/ctis-public/view/2025-521020-30-00